EU clinical trial 2023-504632-17-00: A phase 2, Multicenter Study of TILs Treatment in Advanced Tumors with Alterations in the SWI/SNF Complex: the TILTS Study
Sponsor: Fundacio Institut D Investigacio Biomedica De Bellvitge IDIBELL (Educational Institution). Phase: Therapeutic exploratory (Phase II). Countries: Spain (ended).
Therapeutic area(s): Diseases [C] - Neoplasms [C04]
Gender: Female, Male. Age: 18-64 years, 65+ years. Enrolment: 11.
Status: Ended. Start date (EU): 2024-08-14. End date (EU): 2026-06-30. Decision date: 2023-09-04. Results received: No. Last updated: 2025-08-19.

Condition(s): Advanced solid tumors
Product: PROLEUKIN, 18x106 UI polvo para solución inyectable o para perfusión, Genoxal 1.000 mg polvo para solución inyectable y para perfusión, Tumor Infiltrating Lymphocytes (TILs), Fludarabina Teva 25 mg/ml concentrado para solución para perfusión o inyección EFG

Primary endpoint: • ORR per RECIST v1.1 as assessed by investigator
Endpoint(s): • Toxicity evaluation: nature and frequency of Adverse Events (AE), Severe Adverse Events (SAE), Treatment-limiting Toxicity (TLT), alterations in clinical, laboratory test results, ECGs, vital sign measurements, physical examination findings graded, when applicable, according to the National Cancer Institute (NCI) Common Terminology Criteria for Adverse Events (CTCAE) v5.0., • CRR per RECIST v1.1 as assessed by investigator, • DOR per RECIST v1.1 as assessed by investigator, • DCR per RECIST v1.1 as assessed by investigator, • PFS per RECIST v1.1 as assessed by investigator, OS

Source: https://euclinicaltrials.eu/ctis-public/view/2023-504632-17-00